EU clinical trial 2024-514622-22-00: A study to compare how different substances (caffeine, warfarin, omeprazole, metoprolol, and midazolam) are handled by the body of healthy people and people with liver cirrhosis
Protocol code: 0352-2190
Sponsor: Boehringer Ingelheim International GmbH (Pharmaceutical company). Phase: Human Pharmacology (Phase I)- Other. Countries: Germany (ended).
Therapeutic area(s): Diseases [C] - Nutritional and Metabolic Diseases [C18]
Gender: Female, Male. Age: 18-64 years, 65+ years. Enrolment: 30.
Status: Ended. Start date (EU): 2023-04-25. End date (EU): 2024-12-31. Decision date: 2024-07-26. Results received: No. Last updated: 2024-07-26.

Condition(s): 1. Patients with compensated liver cirrhosis due to any underlying liver disease with advanced fibrosis (F4) and hepatic impairment that meets the criteria for Child-Pugh A 2. Patients with decompensated liver cirrhosis due to any underlying liver disease with advanced fibrosis (F4) and hepatic impairment that meets the criteria for Child-Pugh B

Source: https://euclinicaltrials.eu/ctis-public/view/2024-514622-22-00